EU clinical trial 2023-503449-79-00: A Phase 1 Study to Assess Mass Balance, Pharmacokinetics, and Metabolism of [14C]Subasumstat in Patients With Advanced or Metastatic Solid Tumors
Protocol code: TAK-981-1004
Sponsor: Takeda Development Center Americas Inc. (Pharmaceutical company). Phase: Human Pharmacology (Phase I)- Other. Countries: Hungary (ended).
Therapeutic area(s): Diseases [C] - Neoplasms [C04]
Gender: Female, Male. Age: 18-64 years, 65+ years. Enrolment: 6.
Status: Ended. Start date (EU): 2023-10-10. End date (EU): 2024-07-16. End date: 2024-07-17. Decision date: 2023-09-21. Results received: No. Last updated: 2024-02-08.

Condition(s): Advanced or Metastatic Solid Tumours

Source: https://euclinicaltrials.eu/ctis-public/view/2023-503449-79-00